EU clinical trial 2025-520896-13-00: A Phase 3, 2-Part, Randomized, Double-Blind, Placebo-Controlled Study (Part 1) and Open-Label Extension (Part 2) to Evaluate the Efficacy, Safety, Pharmacokinetics, and Pharmacodynamics of Omaveloxolone (BIIB141) in Participants With Friedreich’s Ataxia Aged 2 to < 16 Years
Protocol code: 296FA301
Sponsor: Biogen Idec Research Limited (Pharmaceutical company). Phase: Therapeutic confirmatory (Phase III). Countries: Ireland (ongoing, recruiting), Spain (ongoing, recruiting), France (ongoing, recruiting), Netherlands (ongoing, recruiting), Austria (ongoing, recruiting), Italy (ongoing, recruiting), Denmark (ongoing, recruiting), Germany (ongoing, recruiting).
Therapeutic area(s): Diseases [C] - Nervous System Diseases [C10]
Gender: Female, Male. Age: 0-17 years. Enrolment: 127.
Status: Ongoing, recruiting. Start date (EU): 2025-12-04. Decision date: 2025-10-28. Results received: No. Last updated: 2026-05-11.
Decision dates by country: ES: 2025-10-29, AT: 2025-11-03, DK: 2025-10-28, IE: 2025-10-31, NL: 2025-11-06, DE: 2025-10-29, IT: 2025-10-30, FR: 2025-11-03

Condition(s): Friedreich’s ataxia
Product: Hard capsules, BIIB141

Primary endpoint: Part 1 Primary Efficacy Endpoint •Change from baseline in USS (mFARS, Section E), Secondary Efficacy Endpoints •Change from baseline in FA-HI •Change from baseline in mFARS •Change from baseline in PGI-S and CGI-S •Change from baseline in FA-ADL, Part 2 •Incidence of AEs and SAEs •Change from baseline in ECHO •Change from baseline in height, weight, and BMI •C-SSRS •Tanner scale
Endpoint(s): Part 1 •Incidence of AEs and SAEs during the treatment period •Change from baseline in ECHO •Change from baseline in height, weight, and BMI •C-SSRS •Tanner scale •PK: Plasma concentrations of omaveloxolone by visit and timepoints, Part 2 Secondary Efficacy Endpoints: •Change from baseline in mFARS, including USS •Change from baseline in FA-ADL •Change from baseline in FA-HI •Change from baseline in PGI-S and CGI-S

Source: https://euclinicaltrials.eu/ctis-public/view/2025-520896-13-00